EU clinical trial 2023-505127-31-00: A Phase 1b Study of Imvotamab in Moderate to Severe Rheumatoid Arthritis
Protocol code: IGM-2323-102
Sponsor: IGM Biosciences Inc. (Pharmaceutical company). Phase: Human Pharmacology (Phase I)- Other. Countries: Poland (ended).
Therapeutic area(s): Diseases [C] - Immune System Diseases [C20]
Gender: Female, Male. Age: 18-64 years, 65+ years. Enrolment: 9.
Status: Ended. Start date (EU): 2024-02-08. End date (EU): 2025-02-10. End date: 2025-02-11. Decision date: 2023-11-30. Results received: No. Last updated: 2024-10-28.

Condition(s): Rheumatoid Arthritis

Source: https://euclinicaltrials.eu/ctis-public/view/2023-505127-31-00